EU clinical trial 2024-518408-32-00: An open-label, multi-center, phase 2 study of chemo-immunotherapy followed by reduced-dose hypofractionated RT and maintenance immunotherapy for stage III unresectable NSCLC
Protocol code: DEDALUS
Sponsor: Fondazione IRCCS Policlinico San Matteo (Hospital/Clinic/Other health care facility). Phase: Therapeutic exploratory (Phase II). Countries: Italy (ongoing, recruitment ended).
Therapeutic area(s): Diseases [C] - Neoplasms [C04]
Gender: Female, Male. Age: 18-64 years, 65+ years. Enrolment: 45.
Status: Ongoing, recruitment ended. Start date (EU): 2024-12-03. Decision date: 2024-12-03. Results received: No. Last updated: 2024-12-03.

Condition(s): Non Small Cell Lung Cancer
Product: DURVALUMAB

Primary endpoint: Grade 3 and Grade 4 PRAEs
Endpoint(s): - Median PFS according to RECIST 1.1 as assessed by the Investigator - PFS6 and PFS12 (12 months) according to RECIST 1.1 as assessed by the Investigator - Median OS and OS12 (12 months)

Source: https://euclinicaltrials.eu/ctis-public/view/2024-518408-32-00